EU clinical trial 2024-515241-41-00: A Phase 2b multi-national, multi-center, randomized, double-blind, placebo-controlled, dose-ranging study followed by a long-term extension to evaluate the efficacy and safety of brivekimig in adult participants with moderate to severe ulcerative colitis.
Protocol code: ACT18134
Sponsor: Sanofi-Aventis Recherche & Developpement (Pharmaceutical company). Phase: Therapeutic exploratory (Phase II). Countries: Germany (authorised, recruiting), Czechia (ongoing, recruitment ended), France (ongoing, recruitment ended), Spain (ongoing, recruitment ended), Poland (ongoing, recruitment ended), Hungary (ongoing, recruitment ended).
Therapeutic area(s): Diseases [C] - Digestive System Diseases [C06]
Gender: Female, Male. Age: 18-64 years, 65+ years. Enrolment: 57.
Start date (EU): 2025-09-10. Decision date: 2025-08-04. Results received: No. Last updated: 2026-04-27.
Decision dates by country: HU: 2025-08-07, ES: 2025-08-08, CZ: 2025-08-05, DE: 2025-08-07, FR: 2025-08-04, PL: 2025-08-11

Condition(s): Ulcerative Colitis
Product: SAR442970, NANOBODY® Placebo

Primary endpoint: Proportion of participants who achieve clinical remission at the end of Week 16 by mMS. Clinical remission is defined as an mMS score of 0 to 2, including SF subscore of 0 or 1, RB subscore of 0, and mMES of 0 or 1 confirmed by central reader (score of 1 does not include friability)./
Endpoint(s): Proportion of participants who achieve endoscopic improvement at Week 16. Endoscopic improvement is defined as an mMES of 0 or 1 (where 1 does not include friability)., Proportion of participants who achieve endoscopic response at Week 16. Endoscopic response is defined as an mMES decrease of at least 1., Proportion of participants who achieve endoscopic remission at Week 16. Endoscopic remission is defined as mMES of 0 confirmed by central reader., Proportion of participants who achieve endoscopic improvement at Week 52. Endoscopic improvement is defined as an mMES of 0 or 1 (where 1 does not include friability)., Proportion of participants who achieve clinical remission at Week 16 by total MS defined as MS ≤2 with no subscore >1., Proportion of participants who achieve clinical response at Week 16 by total MS. Clinical response by total MS is defined as a decrease from baseline in the MS of ≥3 points and at least 30% reduction from baseline, and a decrease in the RB subscore of ≥1 or an absolute RB subscore of 0 or 1., Proportion of participants who achieve clinical response at Week 16 by mMS. Clinical response by mMS is defined as a decrease from baseline in the mMS of ≥2 points and an improvement of ≥30% from baseline plus a decrease in RB subscore ≥1 or an absolute RB subscore ≤1., Proportion of participants who achieve clinical remission at Week 52 by mMS. Clinical remission is defined as an mMS score of 0 to 2, including SF subscore of 0 or 1, RB subscore of 0, and mMES of 0 or 1 confirmed by central reader (score of 1 does not include friability)., Change from baseline in IBDQ at Week 16 to capture the patient’s experience of IBD on 4 domains of functioning and well-being: bowel and systemic symptoms and emotional and social function., Serum brivekimig concentrations throughout the study., Incidence of ADAs over time., Number (percentage) of participants with any TEAEs during the Induction and Maintenance treatment periods., Number (percentage) of participants with any TEAEs during the LTE period., Change from baseline in IBDQ at Week 52.

Source: https://euclinicaltrials.eu/ctis-public/view/2024-515241-41-00